EU clinical trial 2023-508207-21-00: A Phase 1/2 Study of Relatlimab (anti-LAG-3 Monoclonal Antibody) Administered in Combination with Both Nivolumab (anti-PD-1 Monoclonal Antibody) and BMS-986205 (IDO1 inhibitor) or in Combination with Both Nivolumab and Ipilimumab (anti-CTLA-4 Monoclonal Antibody) in Advanced Malignant Tumors
Protocol code: CA224-048
Sponsor: Bristol Myers Squibb International Corporation (Pharmaceutical company). Phase: Phase I and Phase II (Integrated)- Other. Countries: Italy (ended), France (ended), Spain (ended).
Therapeutic area(s): Diseases [C] - Neoplasms [C04]
Gender: Female, Male. Age: 18-64 years, 65+ years. Enrolment: 130.
Status: Ended. Start date (EU): 2019-02-08. End date (EU): 2025-02-14. End date: 2025-02-20. Decision date: 2024-03-19. Results received: Yes. Last updated: 2025-02-04.
Decision dates by country: FR: 2024-04-03, IT: 2024-03-21, ES: 2024-03-19

Condition(s): Advanced Malignant Tumors
Product: linrodostat mesylate; IDO1 inhibitor, linrodostat mesylate; IDO1 inhibitor, Ipilimumab, Relatlimab intravenous, OPDIVO 10 mg/mL concentrate for solution for infusion., linrodostat mesylate; IDO1 inhibitor, Ipilimumab

Primary endpoint: Number of clinical laboratory test abnormalities, Number of Adverse Events (AEs), Number of Serious Adverse Events (SAEs), Number of AEs meeting protocol defined dose-limiting toxicity (DLT) criteria, Number of AEs leading to discontinuation and deaths, Objective Response Rate (ORR), Disease Control Rate (DCR), Median Duration of Response (mDOR)
Endpoint(s): Progression Free Survival (PFS)

Source: https://euclinicaltrials.eu/ctis-public/view/2023-508207-21-00